EU clinical trial 2023-509868-20-00: De-Escalation of Antiplatelet Therapy to Evaluate Platelet Reactivity and Clinical Outcomes after Coronary Stenting in Patients at High Bleeding Risk and Recent Acute Coronary Syndrome: DESC-HBR trial
Protocol code: DESC-HBR
Sponsor: Azienda Ospedaliera Universitaria Gaetano Martino Messina (Hospital/Clinic/Other health care facility). Phase: Therapeutic confirmatory (Phase III). Countries: Italy (ongoing, recruiting).
Therapeutic area(s): Diseases [C] - Cardiovascular Diseases [C14]
Gender: Female, Male. Age: 18-64 years, 65+ years. Enrolment: 200.
Status: Ongoing, recruiting. Start date (EU): 2023-06-24. Decision date: 2024-05-14. Results received: No. Last updated: 2024-05-14.

Condition(s): Acute coronary syndrome
Product: TICAGRELOR, ACETYLSALICYLIC ACID, TICAGRELOR, CLOPIDOGREL DOC Generici 75 mg compresse rivestite con film, PRASUGREL, Prasugrel Mylan 10 mg film-coated tablets

Primary endpoint: The primary endpoint of the study is the incidence of optimal platelet reactivity (OPR) measured by means of the VerifyNow system (Accumetrics, San Diego, CA, USA), 2 hours after drug MD at 14±2 days from study inclusion. OPR will be defined as a PRU between 85 and 208 reactivity units according to international expert consensus
Endpoint(s): Key secondary endpoint of the study is the incidence of nuisance, minor or major bleeding according to the BARC definition (BARC 1-5)., Platelet reactive units (PRU) at VerifyNow system before first randomized treatment administration (baseline), 2 hours after the first randomized treatment administration and before MD at 14±2 days from study inclusion., The proportion of high platelet reactivity (HPR) defined as PRU > 208, and the proportion of low platelet reactivity (LPR), defined as PRU < 85, measured through the VerifyNow system before first randomized treatment administration (baseline), 2 hours after the first randomized treatment administration, before MD at 14±2 days from study inclusion and at 2 hours after drug MD administration at 14±2 days from study inclusion. PRU at 1 and 2 weeks after P2Y12 inhibitor discontinuation study in pa, Platelet-derived thrombogenicity at Total Thrombus Formation (T-TAS) before first randomized treatment administration (baseline), 2 hours after the first randomized treatment administration, before and after MD at 14±2 days from study inclusion, Adverse clinical events, assessed at each visit and up to 5 months after randomization. They include: death, cardiac death, non-fatal myocardial infarction, non-fatal stroke, urgent target vessel revascularization, definite/probable stent thrombosis and net adverse clinical events., Cost-effectives analysis will be also carried out by inputting direct and indirect costs in relation to outcomes assessed., Other: Health mobility and mental scales (i.e. EQ-5D-5L, SF-12); Perceived stress (i.e. PPS); Modified Borg Dyspnoea Scale, non-adherence according to the non-adherence academic research consortium (NARC) scale

Source: https://euclinicaltrials.eu/ctis-public/view/2023-509868-20-00